EU clinical trial 2025-522231-34-00: A Randomized, Double-masked, Parallel-group, Multicenter Clinical Study to Evaluate the Efficacy and Safety of AVT29 Compared with Eylea High Dose (HD) in Participants with Diabetic Macular Edema (ALVOEYE-HD)
Protocol code: AVT29-GL-C01
Sponsor: Alvotech Swiss AG (Pharmaceutical company). Phase: Therapeutic confirmatory (Phase III). Countries: Latvia (ongoing, recruiting), Slovakia (ongoing, recruiting), Czechia (ongoing, recruiting), Hungary (ongoing, recruiting), Poland (ongoing, recruiting), Bulgaria (ongoing, recruiting).
Therapeutic area(s): Diseases [C] - Eye Diseases [C11]
Gender: Female, Male. Age: 18-64 years, 65+ years. Enrolment: 172.
Status: Ongoing, recruiting. Start date (EU): 2026-03-31. Decision date: 2026-03-06. Results received: No. Last updated: 2026-05-29.
Decision dates by country: BG: 2026-03-11, CZ: 2026-03-09, HU: 2026-03-12, LV: 2026-03-06, PL: 2026-03-13, SK: 2026-03-09

Condition(s): Diabetic Macular Edema
Product: Aflibercept, Eylea 114.3 mg/ml solution for injection

Primary endpoint: Change from baseline in best-corrected visual acuity (BCVA) as measured by the Early Treatment Diabetic Retinopathy Study (ETDRS) letter score
Endpoint(s): Change from baseline in BCVA as assessed by ETDRS letter score throughout the study at several pre-defined time points, Gain of ≥5, ≥10, and ≥15 letter score in BCVA by ETDRS from baseline throughout the study at several pre-defined time points, Loss of ≥5, ≥10, and ≥15 letter score in BCVA by ETDRS from baseline throughout the study at several pre-defined time points, Change from baseline in central subfield thickness (CST) as assessed by spectral domain optical coherence tomography (SD-OCT) throughout the study at several pre-defined time points, Absence of intraretinal fluid (IRF) as assessed by SD-OCT from baseline throughout the study at several pre-defined time points, Absence of intraretinal fluid (IRF) as assessed by SD-OCT from baseline throughout the study at several pre-defined time points during the trial, Incidence of ocular and non-ocular treatment-emergent adverse events, adverse events of special interest, and serious adverse events, Evaluation of ophthalmic parameters (intraocular pressure [IOP], biomicroscopy, and indirect ophthalmoscopy), Evaluation of routine safety parameters, Incidence and titer of anti-drug antibodies at several pre-defined time points during the study, Incidence of neutralizing antibodies at several pre-defined time points during the study, Evaluation of the systemic PK of free and bound aflibercept at several pre-defined time points during the study

Source: https://euclinicaltrials.eu/ctis-public/view/2025-522231-34-00